EU clinical trial 2024-513718-37-00: PREVENE : Preemptive therapy with Venetoclax for high risk CLL stage A patients, a phase II trial of the FILO
Protocol code: FILOCLL10-PREVENE
Sponsor: French Innovative Leukemia Organization (Laboratory/Research/Testing facility). Phase: Therapeutic exploratory (Phase II). Countries: France (ongoing, recruitment ended).
Therapeutic area(s): Diseases [C] - Hemic and Lymphatic Diseases [C15]
Gender: Female, Male. Age: 18-64 years, 65+ years. Enrolment: 45.
Status: Ongoing, recruitment ended. Start date (EU): 2024-08-01. Decision date: 2024-08-01. Results received: No. Last updated: 2026-07-23.

Condition(s): IGHV unmutated patients with high-risk stage A CLL features.

Source: https://euclinicaltrials.eu/ctis-public/view/2024-513718-37-00